EU clinical trial 2023-505839-12-01: BIomarker-dRiven Dosing Interval Extension of biologics in asthma (the BIRDIE trial)
Sponsor: Sint Franciscus Vlietland Groep Stichting (Hospital/Clinic/Other health care facility). Phase: Therapeutic confirmatory (Phase III). Countries: Netherlands (ongoing, recruiting).
Therapeutic area(s): Diseases [C] - Respiratory Tract Diseases [C08]
Gender: Female, Male. Age: 18-64 years, 65+ years. Enrolment: 80.
Status: Ongoing, recruiting. Start date (EU): 2024-02-26. Decision date: 2023-09-26. Results received: No. Last updated: 2025-12-03.

Condition(s): Severe asthma
Product: Nucala 100 mg powder for solution for injection, Dupixent 100 mg solution for injection in pre-filled syringe

Primary endpoint: The main study endpoint is the number of injections in the mepolizumab and in the dupilumab intervention group compared to the control groups during the follow-up period.

Source: https://euclinicaltrials.eu/ctis-public/view/2023-505839-12-01